EU clinical trial 2024-519638-22-00: A multicenter open-label extension study to evaluate the long-term safety and tolerability of zigakibart in adults with primary IgA nephropathy
Protocol code: CFUB523A12302B
Sponsor: Novartis Pharma AG (Pharmaceutical company). Phase: Therapeutic confirmatory (Phase III). Countries: Belgium (authorised, recruitment pending), France (authorised, recruitment pending), Czechia (authorised, recruitment pending), Croatia (authorised, recruitment pending), Greece (authorised, recruitment pending), Germany (authorised, recruitment pending), Italy (authorised, recruitment pending), Spain (authorised, recruitment pending).
Therapeutic area(s): Diseases [C] - Immune System Diseases [C20]
Gender: Female, Male. Age: 18-64 years, 65+ years. Enrolment: 69.
Status: Authorised, recruitment pending. Decision date: 2026-05-04. Results received: No. Last updated: 2026-08-05.
Decision dates by country: BE: 2026-05-04, HR: 2026-05-11, CZ: 2026-05-04, FR: 2026-05-04, DE: 2026-05-06, GR: 2026-05-04, IT: 2026-05-05, ES: 2026-05-07

Condition(s): IgA nephropathy
Product: Bion 1301/FUB523

Primary endpoint: Type, incidence, severity, seriousness, and relatedness of treatment-emergent adverse events (TEAEs), Incidence, severity, seriousness, and relatedness of adverse events of special interest (AESI)
Endpoint(s): Change from Baseline to Weeks 48 and 96 in UPCR based on 24h-urine collection, Change from Baseline to Week 96 in eGFR, using the chronic kidney disease-epidemiology collaboration (CKD-EPI) creatinine equation, Change from BEYOND parent study Baseline to Week 96 of OLE study in eGFR, Serum concentrations of zigakibart, Changes from baseline in immunoglobulin levels, Presence of circulating binding and neutralizing antidrug antibodies (ADA/Nab), Safety laboratory parameters and vital signs

Source: https://euclinicaltrials.eu/ctis-public/view/2024-519638-22-00